EU clinical trial 2024-515146-16-00: PROPHYLOXITIN-Intermittent cefoxitin administration versus loading bolus followed by continuous infusion for the prevention of surgical site infection in colorectal surgery: a multicentre, double-blind, randomized controlled clinical trial
Protocol code: PROPHYLOXITIN
Sponsor: Centre Hospitalier Universitaire De Poitiers (Hospital/Clinic/Other health care facility). Phase: Therapeutic confirmatory (Phase III). Countries: France (ended).
Therapeutic area(s): Analytical, Diagnostic and Therapeutic Techniques and Equipment [E] - Anesthesia and Analgesia [E03]
Gender: Female, Male. Age: 18-64 years, 65+ years. Enrolment: 2000.
Status: Ended. Start date (EU): 2023-05-15. End date (EU): 2026-07-13. Decision date: 2024-08-20. Results received: No. Last updated: 2026-04-23.

Condition(s): Colorectal surgery
Product: CHLORURE DE SODIUM 0,9 % AGUETTANT, solution pour perfusion, CEFOXITINE PANPHARMA 1 g, poudre pour solution injectable (IV)

Primary endpoint: Proportion of patients with any SSI within 30 days after surgery.
Endpoint(s): Proportion of patients with each type of SSI (superficial, deep and/or organ–space infection), Proportion of patients with surgical reintervention, Proportion of patients with anastomotic leak, Proportion of patients with postoperative complication according to the Dindo and Clavien classification, Proportion of patients with Clostridium difficile infection, Hospital readmission censored at day 30, Unexpected admission to the ICU censored at day 30, Duration of hospital stay and hospital free days, All-causes mortality, Proportion of per operative adverse events

Source: https://euclinicaltrials.eu/ctis-public/view/2024-515146-16-00